EU clinical trial 2022-501892-14-00: Evaluation of PSMA-PET and mpMRI in high-risk prostate cancer – using histopathologic validation
Protocol code: PAMP2
Sponsor: Region Vasterbotten, Umea University (Hospital/Clinic/Other health care facility, Educational Institution). Phase: Therapeutic confirmatory (Phase III). Countries: Sweden (ongoing, recruiting).
Therapeutic area(s): Analytical, Diagnostic and Therapeutic Techniques and Equipment [E] - Investigative Techniques [E05]; Diseases [C] - Neoplasms [C04]; Diseases [C] - Male Urogenital Diseases [C12]
Gender: Male. Age: 18-64 years, 65+ years. Enrolment: 20.
Status: Ongoing, recruiting. Start date (EU): 2024-10-14. Decision date: 2024-03-25. Results received: No. Last updated: 2024-03-25.

Condition(s): Prostate cancer
Product: 18F-PSMA-1007, Buscopan 20 mg/ml injektionsvätska, lösning, Dotarem 279,3 mg/ml injektionsvätska lösning, Glucagon Novo Nordisk 1 mg pulver och vätska till injektionsvätska, lösning

Primary endpoint: The primary endpoint is spatially defined aggressive PC lesions, or subparts of lesions, identified and defined using PSMA-PET and/or mpMRI compared to histopathology
Endpoint(s): The secondary endpoints are biochemical disease-free survival, time to relapse, overall survivor and surgical margins., The secondary endpoint is to the assess the radiological extracapsular extension and seminal vesicle involvement in comparison to histopathological evaluation., The exploratory endpoint of the study is also the spatially defined most aggressive PC lesions, or subparts of lesions., The safety endpoint is subject-reported adverse events up to one week after treatment.

Source: https://euclinicaltrials.eu/ctis-public/view/2022-501892-14-00